EU clinical trial 2023-506314-51-00: A Phase 1/2 Open-Label Rolling-Arm Umbrella Platform Design of Investigational Agents With or Without Pembrolizumab or Pembrolizumab Alone in Participants with Melanoma (KEYMAKER-U02): Substudy 02C
Protocol code: MK-3475-02C
Sponsor: Merck Sharp & Dohme LLC (Pharmaceutical company). Phase: Phase I and Phase II (Integrated)- Other. Countries: France (ended), Italy (ended).
Therapeutic area(s): Diseases [C] - Neoplasms [C04]
Gender: Female, Male. Age: 18-64 years, 65+ years. Enrolment: 29.
Status: Ended. Start date (EU): 2020-07-31. End date (EU): 2025-09-09. End date: 2025-09-24. Decision date: 2024-02-14. Results received: No. Last updated: 2025-09-09.
Decision dates by country: IT: 2024-02-14, FR: 2024-04-24

Condition(s): Stage IIIB or IIIC or IIID melanoma
Product: TRETINOIN, gebasaxturev, MK-4280A, vibostolimab, MK-4830, KEYTRUDA 25 mg/mL concentrate for solution for infusion

Primary endpoint: Percentage of participants who experience an adverse event (AE), Percentage of participants who discontinue study treatment due to an AE, Pathological complete response (pCR) rate
Endpoint(s): Near pathological complete response (near pCR) rate, Pathological partial response (pPR) rate, Recurrence-free survival (RFS)

Source: https://euclinicaltrials.eu/ctis-public/view/2023-506314-51-00